EU clinical trial 2025-524050-34-01: Use of DOTATOC labeled with V-Cu64 in PET-CT imaging of neuroendocrine tumors
Protocol code: CuDota25
Sponsor: Voxel S.A. (Laboratory/Research/Testing facility). Phase: Therapeutic confirmatory (Phase III). Countries: Poland (not authorised).
Therapeutic area(s): Diseases [C] - Neoplasms [C04]
Gender: Female, Male. Age: 18-64 years. Enrolment: 80.
Status: Not authorised. Decision date: 2026-06-01. Results received: No. Last updated: 2026-06-01.

Condition(s): Neoplasms
Product: V-Ga68 500 MBq/mL, prekursor radiofarmaceutyku, roztwór, V-Cu64, GALLIUM (68GA) EDOTREOTIDE, SomaKit TOC 40 micrograms kit for radiopharmaceutical preparation

Primary endpoint: Demonstration of the bioequivalence of the V-Cu64 radiopharmaceutical precursor to 68Ga based on number of visualized lesions between interventions. Number of visualized lesions (visualization of at least the same lesions between interventions) for 95% of the study population, Demonstration of bioequivalence of the V-Cu64 radiopharmaceutical precursor to 68Ga based on: SUV_MAX measurement of lesions imaged in both interventions. Accuracy in SUV_MAX measurement of lesions imaged in both interventions, SUV_MAX in the copper study not less than 90% of SUV_MAX in the 68Ga study for each lesion for 95% of the population, averaged result for descriptions by two independent physicians.
Endpoint(s): Safety monitoring. Collection of data on adverse events

Source: https://euclinicaltrials.eu/ctis-public/view/2025-524050-34-01